EU clinical trial 2023-510058-17-00: A PHASE I, OPEN-LABEL, RANDOMIZED, ADAPTIVE, CROSS-OVER STUDY TO DETERMINE THE RELATIVE BIOAVAILABILITY OF NIZUBAGLUSTAT CAPSULES COMPARED TO ORALLY DISPERSIBLE TABLETS AND THE FOOD EFFECT IN HEALTHY VOLUNTEERS
Protocol code: AZA-001-31-03
Sponsor: Azafaros B.V. (Pharmaceutical company). Phase: Human Pharmacology (Phase I)- Other. Countries: Netherlands (ended).
Therapeutic area(s): Diseases [C] - Nutritional and Metabolic Diseases [C18]
Gender: Female, Male. Age: 18-64 years, 65+ years. Enrolment: 24.
Status: Ended. Start date (EU): 2024-03-12. End date (EU): 2025-01-06. Decision date: 2024-02-27. Results received: No. Last updated: 2025-01-13.

Condition(s): Glycosphingolipid lysosomal storage disorders

Source: https://euclinicaltrials.eu/ctis-public/view/2023-510058-17-00